EU clinical trial 2024-520082-31-01: Long-term effect of Dupilumab on acetylsalicylic acid (ASA) intolerance and its mechanisms in patients with non-steroidal anti-inflammatory drug-exacerbated respiratory disease (N-ERD)
Sponsor: Medical University Of Vienna (Educational Institution). Phase: Therapeutic use (Phase IV). Countries: Austria (authorised, recruitment pending).
Therapeutic area(s): Diseases [C] - Immune System Diseases [C20]
Gender: Female, Male. Age: 18-64 years, 65+ years. Enrolment: 30.
Status: Authorised, recruitment pending. Decision date: 2025-05-20. Results received: No. Last updated: 2025-05-20.

Condition(s): non-steroidal anti-inflammatory drug-exacerbated respiratory disease (N-ERD)
Product: Dupixent 300 mg solution for injection in pre-filled syringe

Primary endpoint: Tolerated aspirin dose levels as tested with different dosages (62.5mg, 125mg, 250mg and 500 mg) compared to tolerated dosages before and 6 months into Dupilumab treatment.
Endpoint(s): 1. Serum ECP, total IgE, allergen specific IgE, tryptase, peripheral blood eosinophils 2. Allergenic sensitization as assessed by skin prick and blood test 3. Olfactory performance 4. Prostaglandin levels in urine 5. Cytokine pattern in nasal secretions 6. Inflammatory cytokine patterns at mRNA levels 7. Nasal microbiome composition 8. TPS, VAS, SNOT-22 9. ACT, ACQ

Source: https://euclinicaltrials.eu/ctis-public/view/2024-520082-31-01